EU clinical trial 2024-516237-12-00: TRIBECA - Multicenter randomized double-blind study comparing the efficacy and safety of belimumab in the treatment of non-infectious active cryoglobulinemia vasculitis compared to placebo TRIBECA STUDY (Treatment after RItuximab with BElimumab in mixed Cryoglobulinemia Associated vasculitis)
Protocol code: APHP180351
Sponsor: Assistance Publique Hopitaux De Paris (Hospital/Clinic/Other health care facility). Phase: Therapeutic exploratory (Phase II). Countries: France (ongoing, recruiting).
Therapeutic area(s): Diseases [C] - Immune System Diseases [C20]
Gender: Female, Male. Age: 18-64 years, 65+ years. Enrolment: 52.
Status: Ongoing, recruiting. Start date (EU): 2021-10-20. Decision date: 2024-11-20. Results received: No. Last updated: 2024-11-20.

Condition(s): Cryoglobulinemia vasculitis
Product: Benlysta 200 mg solution for injection in pre-filled syringe., Placebo of belimumab

Primary endpoint: Complete clinical response rate of vasculitis symptoms at week (W) 25 with oral corticosteroid withdrawal (prednisone (or prednisolone, only if prednisone is out of stock in the market) at 0 mg/day) at week (W) 12.
Endpoint(s): •Safety and tolerability of treatments as assessed by frequency and severity of adverse clinical events at W25 and at W48 •Complete, partial and non-clinical response rate at W13, W25 and at W48. •Complete renal response rate at W13, W25 and W48 • Rate of cryoglobulinemia clearance, of negativation of rheumatoid factor activity and of normalization of C4 complement level at W13, W25 and at W48 •Rate of early failures (non clinical response at W5)

Source: https://euclinicaltrials.eu/ctis-public/view/2024-516237-12-00